EU clinical trial 2024-512420-10-00: Safety, tolerability, pharmacokinetics, and pharmacodynamics of intravenous and subcutaneous multiple rising doses of BI 765250 versus placebo in trial participants with moderate to severe plaque psoriasis (double-blind, randomised, placebo-controlled, parallel-group design)
Protocol code: 1474-0002
Sponsor: Boehringer Ingelheim International GmbH, Boehringer Ingelheim RCV GmbH & Co. KG (Pharmaceutical company). Phase: Human Pharmacology (Phase I)- Other. Countries: Bulgaria (ended), Romania (ended).
Therapeutic area(s): Diseases [C] - Skin and Connective Tissue Diseases [C17]
Gender: Female, Male. Age: 18-64 years, 65+ years. Enrolment: 31.
Status: Ended. Start date (EU): 2023-03-09. End date (EU): 2025-02-24. End date: 2025-02-25. Decision date: 2024-10-25. Results received: No. Last updated: 2024-11-06.
Decision dates by country: BG: 2024-10-25, RO: 2024-11-06

Condition(s): Plaque psoriasis

Source: https://euclinicaltrials.eu/ctis-public/view/2024-512420-10-00